EU clinical trial 2024-520027-88-00: PHASE II STUDY TO EVALUATE THE EFFICACY AND SAFETY OF CAMIZESTRANT PLUS RIBOCICLIB IN PATIENTS WITH HORMONE RECEPTOR-POSITIVE (HR+) BREAST CANCER (THE CADILLAC STUDY)
Protocol code: MEDOPP0555
Sponsor: Medica Scientia Innovation Research S.L. (Pharmaceutical company). Phase: Therapeutic exploratory (Phase II). Countries: Spain (ongoing, recruiting), Germany (authorised, recruitment pending).
Therapeutic area(s): Diseases [C] - Neoplasms [C04]
Gender: Female, Male. Age: 18-64 years, 65+ years. Enrolment: 131.
Start date (EU): 2026-02-12. Decision date: 2025-12-23. Results received: No. Last updated: 2026-08-06.
Decision dates by country: DE: 2025-12-23, ES: 2026-01-30

Condition(s): Patients with hormone receptor-positive (HR+) breast cancer
Product: RIBOCICLIB, Camizestrant

Primary endpoint: PFS, defined as the time from the date of the first dose until disease progression or death from any cause, whichever occurs first (compared to PFS of the historical control arm), as determined locally by the investigator using RECIST v.1.1.
Endpoint(s): ORR, defined as the rate of patients with complete response (CR) or partial response (PR), as determined locally by the investigator using RECIST v.1.1., CBR, defined as the rate of patients with objective response (CR or PR), or stable disease for at least 24 weeks, as determined locally by the investigator using RECIST v.1.1., TTR, defined as the period from treatment initiation to the first objective tumor response (tumor shrinkage of ≥ 30%) observed for patients who achieved a CR or PR, as determined locally by the investigator using RECIST v.1.1., DoR, defined as the period from the first occurrence of a documented objective response to disease progression or death from any cause, whichever occurs first, as determined locally by the investigator using RECIST v.1.1., Best percentage of change from baseline in the size of target tumor lesions, defined as the biggest decrease, or smallest increase if no decrease will be observed, as determined locally by the investigator using RECIST v.1.1., TTSLC, defined as the period from treatment initiation to the subsequent line of chemotherapy as determined locally by the investigator., Changes from baseline in the EORTC quality of life (QLQ-C30), the BC-specific (QLQ-BR42), PRO-CTCAE, Global Items (PGIS, PGIC, PGI-TT), and EQ-5D-5L questionnaires., Safety and tolerability as per NCI-CTCAE v.5.0., Efficacy endpoints for all patients as compared to efficacy endpoints obtained from real world database., Kaplan Meier estimates of PFS and hazard ratio of patients with ESR1 mutation detected versus non-detected, Kaplan-Meier estimates of OS and hazard ratio of patients with ESR1 mutation detected versus non-detected., Mutation profiling, copy number variability, gene expression, multiplex assays, proteomic analyses, digital pathology, immunohistochemistry, taxonomic or functional analyses may be performed in blood and tumor tissue samples of all patients to determine their potential relationship with clinical outcomes, safety, and/or tolerability profile., Association of treatment efficacy and/or safety outcomes in all patients with radiological imaging biomarkers

Source: https://euclinicaltrials.eu/ctis-public/view/2024-520027-88-00